EU clinical trial 2025-520520-17-00: A Phase III, Randomised, Double-Blind, Placebo-Controlled, Parallel Group Study to Assess the Effect of AZD0780 on Low Density Lipoprotein Cholesterol in Patients With Heterozygous Familial Hypercholesterolaemia
Protocol code: D7960C00013
Sponsor: AstraZeneca AB (Pharmaceutical company). Phase: Therapeutic confirmatory (Phase III). Countries: Slovakia (ongoing, recruitment ended), Bulgaria (ongoing, recruitment ended), Spain (ongoing, recruitment ended), Finland (ongoing, recruitment ended), Sweden (ongoing, recruitment ended), France (ongoing, recruitment ended), Norway (ongoing, recruitment ended), Hungary (ongoing, recruitment ended), Netherlands (ongoing, recruitment ended), Czechia (ongoing, recruitment ended), Denmark (ongoing, recruitment ended), Germany (ongoing, recruitment ended).
Therapeutic area(s): Diseases [C] - Cardiovascular Diseases [C14]
Gender: Female, Male. Age: 18-64 years, 65+ years. Enrolment: 152.
Status: Ongoing, recruitment ended. Start date (EU): 2025-09-05. Decision date: 2025-08-18. Results received: No. Last updated: 2026-07-02.
Decision dates by country: CZ: 2025-08-20, NO: 2025-08-20, NL: 2025-08-20, FR: 2025-08-19, BG: 2025-08-21, DK: 2025-08-25, FI: 2025-08-25, SK: 2025-08-18, DE: 2025-09-04, HU: 2025-08-21, ES: 2025-08-21, SE: 2025-08-25

Condition(s): Heterozygous familial hypercholesterolaemia
Product: AZD0780, AZD0780 Placebo

Primary endpoint: Relative change in LDL-C from baseline to 12 weeks
Endpoint(s): Relative change in LDL-C from baseline to 12 weeks (in patients on background statin therapy at baseline), Indicator for LDL-C < 70 mg/dL (< 1.8 mmol/L) at 12 weeks, Indicator for LDL-C < 55 mg/dL (< 1.4 mmol/L) at 12 weeks, Relative change in LDL-C from baseline to 28 weeks, Relative change in LDL-C from baseline to 52 weeks, Relative change in Apo B from baseline to 12 weeks, Relative change in non-HDL-C from baseline to 12 weeks, Relative change in total cholesterol from baseline to 12 weeks, Relative change in Lp(a) from baseline to 12 weeks

Source: https://euclinicaltrials.eu/ctis-public/view/2025-520520-17-00